EU clinical trial 2025-523234-66-00: A Phase 2 Posology Study with Long-Term Extension in Participants with Well‑Controlled Recurrent Pericarditis to Evaluate the Efficacy and Safety of Transition Regimens to KPL-387 Monotherapy from Standard Therapies
Protocol code: KPL-387-C212
Sponsor: Kiniksa Pharmaceuticals GmbH (Pharmaceutical company). Phase: Therapeutic exploratory (Phase II). Countries: Spain (ongoing, recruiting), Greece (ongoing, recruiting), Germany (authorised, recruiting), France (ongoing, recruiting), Italy (ongoing, recruiting), Poland (ongoing, recruiting).
Therapeutic area(s): Analytical, Diagnostic and Therapeutic Techniques and Equipment [E] - Therapeutics [E02]; Diseases [C] - Cardiovascular Diseases [C14]
Gender: Female, Male. Age: 18-64 years, 65+ years. Enrolment: 22.
Start date (EU): 2026-04-17. Decision date: 2026-03-19. Results received: No. Last updated: 2026-08-03.
Decision dates by country: FR: 2026-03-19, DE: 2026-03-24, GR: 2026-03-19, IT: 2026-03-20, ES: 2026-03-24, PL: 2026-03-27

Condition(s): Well-Controlled Recurrent Pericarditis
Product: KPL-387

Primary endpoint: Primary Efficacy Endpoint – Posology Period: Proportion of participants free from Pericarditis Recurrence by Week 16. Only Clinical Endpoint Committee (CEC) confirmed Pericarditis Recurrences will be considered as events for establishment of freedom from Pericarditis Recurrence., Primary Efficacy Endpoint – LTE Period: Annualized rate of Pericarditis Recurrence through the end of the LTE Period. Only CEC-confirmed Pericarditis Recurrences will be considered as events for the analysis in the LTE Period.

Source: https://euclinicaltrials.eu/ctis-public/view/2025-523234-66-00